EU clinical trial 2024-510617-15-00: Perioperative versus adjuvant FOLFIRINOX for resectable pancreatic cancer: the PREOPANC-3 study
Sponsor: Erasmus Universitair Medisch Centrum Rotterdam (Erasmus MC) (Hospital/Clinic/Other health care facility). Phase: Therapeutic confirmatory (Phase III). Countries: Netherlands (ongoing, recruitment ended), Sweden (authorised, recruitment pending).
Therapeutic area(s): Diseases [C] - Neoplasms [C04]
Gender: Female, Male. Age: 18-64 years, 65+ years. Enrolment: 378.
Start date (EU): 2024-09-06. Decision date: 2024-09-06. Results received: No. Last updated: 2024-09-09.
Decision dates by country: SE: 2024-09-09, NL: 2024-09-06

Condition(s): Non-metastatic resectable pancreatic cancer
Product: Irinotecan HCl-trihydraat Accord 20 mg/ml concentraat voor oplossing voor infusie, Oxaliplatine Fresenius Kabi 5 mg/ml concentraat voor oplossing voor infusie, Folinezuur Sandoz 10 mg/ml, oplossing voor injectie, Fluorouracil Accord 50 mg/ml, oplossing voor injectie of infusie

Primary endpoint: Primary endpoint is overall survival by intention to treat

Source: https://euclinicaltrials.eu/ctis-public/view/2024-510617-15-00